EU clinical trial 2023-506716-41-00: KontRASt-03: A Phase Ib/II, multicenter, open-label platform study of JDQ443 with select combinations in patients with advanced solid tumors harboring the KRAS G12C mutation
Protocol code: CJDQ443E12101
Sponsor: Novartis Pharma AG (Pharmaceutical company). Phase: Phase I and Phase II (Integrated)- Other. Countries: Spain (ended), Germany (ended), Belgium (ongoing, recruitment ended), Italy (ongoing, recruitment ended), France (ongoing, recruitment ended).
Therapeutic area(s): Diseases [C] - Neoplasms [C04]
Gender: Female, Male. Age: 18-64 years, 65+ years. Enrolment: 200.
Start date (EU): 2023-05-08. Decision date: 2023-12-18. Results received: No. Last updated: 2026-01-29.
Decision dates by country: DE: 2023-12-19, FR: 2024-01-17, ES: 2023-12-18, BE: 2023-12-22, IT: 2024-01-08

Condition(s): Adult patients with advanced (metastatic or unresectable) KRAS G12C mutant solid tumors
Product: LEE011, TMT212, Mekinist 2 mg film-coated tablets, Mekinist 0.5 mg film-coated tablets, TMT212, JDQ443, CETUXIMAB

Primary endpoint: Dose escalation: Incidence and severity of dose limiting toxicities (DLTs) of each combination treatment., Dose escalation: Incidence and severity of adverse events (AEs) and serious adverse events (SAEs) by treatment, Dose escalation: Frequency of dose interruptions and reductions, by treatment, Dose Escalation: Dose intensity by treatment, Phase II: Overall Response Rate by Blinded Independent Review Committee (BIRC) per RECIST 1.1
Endpoint(s): Dose escalation and Phase II: ORR by local review per RECIST 1.1, Dose escalation and Phase II: Disease Control Rate (DCR) by local review per RECIST 1.1, Dose escalation and Phase II: Duration of Response (DoR) by local review per RECIST 1.1, Dose escalation and Phase II: Progression-Free Survival (PFS) by local review per RECIST 1.1, Phase II: DCR by BIRC per RECIST 1.1, Phase II: DoR by BIRC per RECIST 1.1, Phase II: PFS by BIRC per RECIST 1.1, Phase II: Overall survival (OS)

Source: https://euclinicaltrials.eu/ctis-public/view/2023-506716-41-00